EU clinical trial 2022-500293-34-01: Phase I single arm, dose escalating and phase II double blind, randomized, placebo-controlled dose finding clinical trial assessing safety, and efficacy of intratracheal administration of allogeneic umbilical mesenchymal cells-derived extracellular vesicles in preventing bronchopulmonary dysplasia in extremely preterm newborns.
Protocol code: EVENEW
Sponsor: Exo Biologics (Pharmaceutical company). Phase: Phase I and Phase II (Integrated)- First administration to humans. Countries: Italy (ongoing, recruiting), Belgium (authorised, recruitment pending).
Therapeutic area(s): Diseases [C] - Respiratory Tract Diseases [C08]
Gender: Female, Male. Age: 0-17 years. Enrolment: 265.
Start date (EU): 2023-12-28. Decision date: 2023-07-11. Results received: No. Last updated: 2026-05-29.
Decision dates by country: BE: 2023-07-11, IT: 2023-07-11

Condition(s): Bronchopulmonary Dysplasia
Product: EXOB-001, NaCl 0,9 % B. Braun, solution pour perfusion

Primary endpoint: Phase I: Treatment-emergent adverse events (TEAEs) assessed from EXOB-001 administration up to 36 weeks PMA., Phase II: BPD grade II-III incidence rate per groups assessed at 36 weeks PMA. Severity of BPD assessed according to the modified NICHD severity grading (Grade I to IIIA) definition.
Endpoint(s): Phase I: Treatment-emergent adverse events (TEAEs), and clinical examination and blood tests., Phase I: Dose limiting toxicity measured as: cardiorespiratory decompensation (hypotension with tachycardia, lactic acidosis, oliguria, with echocardiographic confirmation if possible); decrease in SpO2/FiO2 ratio of more than 100 points or increase in FiO2 by > 30% (defined as 30% increase from the baseline, e.g. from 40% to 70%) that persist for at least 4 hours; stable (> 3 hours) increase in required mean airway pressure >3 cm H2O; death; anaphylactic reaction; any serious adverse reaction, Phase II: All adverse events (AEs) and serious adverse events (SAEs) (including case fatalities), both related and non-related., Phase I: Need for oxygen and ventilation support (case definition according to Jobe and Bancalari 2001, case definition according to Isayama et al. 2017]., Phase I: The number of cases and severity of BPD measured according to modified NICHD severity grading (Grade I to IIIA) case definition and according to Jobe and Bancalari 2001 (mild, moderate, severe) case definition. The number of cases of BPD according to Isayama et al. 2017 case definition., Phase I: Lung ultrasound (LUS)., Phase I: Chest X-Ray(s)., Phase I: Functional and anatomic echocardiography., Phase I: Clinical examination, blood tests., Phase I: Number of deaths caused by lung failure., Phase I: All SAEs (including all-cause deaths)., Phase I: Duration of MV/respiratory support (i.e., total time receiving supplemental oxygen). Respiratory Severity Score. Duration of hospitalisation. Assessment of ROP, NEC, IVH, sepsis, PVL, HMD, apnoea, pneumothorax. Concomitant treatments, such as steroids, and surfactant. Concomitant procedures and therapies., Phase I: Occurrence of ROP, NEC, IVH, sepsis, PVL, HMD, apnoea, pneumothorax; concomitant treatments such as steroids and others, procedures and therapies., Phase I: ASQ3 Ages & Stages questionnaire for parents., Phase I: Liverpool Respiratory Symptom Questionnaire (LRSQ)., Phase II: Need for oxygen and ventilation support, and BPD incidence (BPD case definition according to Isayama et al. 2017). Per group., Phase II: Need for oxygen and ventilation support at day 28 chronological age, and BPD incidence and severity rate at 36 weeks PMA (BPD case definition according to Jobe and Bancalari 2001). Per group., Phase II: BPD grade I-II-III incidence rate per group. Severity of BPD assessed according to the modified NICHD severity grading (Grade I to IIIA) definition., Phase II: BPD grade II-III incidence rate in each EXOB-001 group. Severity of BPD assessed according to the modified NICHD severity grading (Grade I to IIIA) definition., Phase II: Chest X-Ray(s). Per group., Phase II: Functional and anatomic echocardiography. Per group., Phase II: Clinical examination, blood tests. Per group., Phase II: Lung ultrasound (LUS). Per group., Phase II: Number of deaths caused by lung failure per group., Phase II: All AEs and SAEs (related and non-related) per group., Phase II: All SAEs (including all-cause deaths). Per group., Phase II: Duration of MV/respiratory support and hospitalisation. Assessment of RSS. Assessment of ROP, NEC, IVH, sepsis, PVL, HMD, apnoea, pneumothorax. Concomitant treatments, such as steroids, and surfactant. Per group., Phase II: Occurrence of ROP, NEC, IVH, sepsis, PVL, HMD, apnoea, pneumothorax. Concomitant treatments such as steroids and others, procedures, and therapies. Per group., Phase II: IL-6, IL-8, TNFa, TGFb1, IL1b and IL1ra. Subset of subjects in all groups., Phase II: ASQ3 Ages and Stages questionnaire for parents. Per group., Phase II: Liverpool Respiratory Symptom Questionnaire (LRSQ). Per group.

Source: https://euclinicaltrials.eu/ctis-public/view/2022-500293-34-01